EU clinical trial 2024-515534-32-00: An investigator-initiated, multi-center, randomized, double-blind, placebo controlled study of Dupilumab to demonstrate efficacy in subjects with nummular eczema
Sponsor: Klinikum rechts der Isar der TU Muenchen AöR (Hospital/Clinic/Other health care facility). Phase: Therapeutic exploratory (Phase II). Countries: Germany (ended).
Therapeutic area(s): Diseases [C] - Skin and Connective Tissue Diseases [C17]
Gender: Female, Male. Age: 18-64 years, 65+ years. Enrolment: 70.
Status: Ended. Start date (EU): 2021-03-15. End date (EU): 2025-09-01. Decision date: 2024-10-24. Results received: Yes. Last updated: 2025-06-24.

Condition(s): Subjects with nummular eczema
Product: Dupixent 300 mg solution for injection in pre-filled syringe

Primary endpoint: Percent change in EASI score from baseline to week 16
Endpoint(s): Number of Patients Achieving an Improvement (Decrease) in Physician Global Assessment (PGA) by two or more points at week 16 as compared to week 0 or achieving an absolute PGA of 0 or 1 at Week 16., Eczema Area and Severity Index (EASI) 50 score at week 16 The proportion of subjects who achieve at least a 50% reduction in the EASI score at Week 16 compared to week 0 (Baseline)., Significant histological improvement at week 16. Assessed by reduction of epidermal thickness > 30% or reduction of inflammatory infiltrate > 50 % compared to histological findings on baseline., Change from Baseline in the Dermatology Life Quality Index (DLQI) Total Score at Week 16., Change from Baseline in Pruritus Visual Analog Scale (VAS) Score at Week 16., Change from Baseline in the Global Satisfaction Subscale of the Treatment Satisfaction Questionnaire for Medication (TSQM) Score at Week 16., Safety of Dupilumab will be assessed by Evaluating Adverse Events (AEs).

Source: https://euclinicaltrials.eu/ctis-public/view/2024-515534-32-00